EU clinical trial 2023-507154-32-00: A Study Evaluating Venetoclax in Combination With Azacitidine in Participants With Treatment-Naïve Higher-Risk Myelodysplastic Syndromes (MDS)
Protocol code: M15-531
Sponsor: AbbVie Deutschland GmbH & Co. KG (Pharmaceutical company). Phase: Human Pharmacology (Phase I)- First administration to humans. Countries: Germany (ended), France (ended).
Therapeutic area(s): Diseases [C] - Hemic and Lymphatic Diseases [C15]
Gender: Female, Male. Age: 18-64 years, 65+ years. Enrolment: 22.
Status: Ended. Start date (EU): 2017-02-17. End date (EU): 2025-12-02. End date: 2026-04-15. Decision date: 2023-11-27. Results received: No. Last updated: 2025-10-27.
Decision dates by country: DE: 2023-11-28, FR: 2023-11-27

Condition(s): Myelodysplastic Syndromes (MDS)

Source: https://euclinicaltrials.eu/ctis-public/view/2023-507154-32-00